EU clinical trial 2024-516617-20-00: Long-term Follow-up study for relapsed/refractory (R/R) T-cell acute lymphoblastic leukemia/lymphoma (T-ALL/LL) patients previously treated with OC-1 cells.
Protocol code: OC-01-23002
Sponsor: Onechain Immunotherapeutics S.L. (Pharmaceutical company). Phase: Therapeutic confirmatory (Phase III). Countries: Spain (ongoing, recruiting).
Therapeutic area(s): Diseases [C] - Neoplasms [C04]; Diseases [C] - Hemic and Lymphatic Diseases [C15]
Gender: Female, Male. Age: 0-17 years, 18-64 years, 65+ years. Enrolment: 20.
Status: Ongoing, recruiting. Start date (EU): 2025-05-21. Decision date: 2025-04-11. Results received: No. Last updated: 2025-04-11.

Condition(s): T-cell acute lymphoblastic Lymphoma, T-cell Acute Lymphoblastic Leukemia
Product: hCD1a-CAR T

Primary endpoint: Number of adverse events grade III-IV, related or possibly related, using Common Toxicity Criteria for Adverse Events (CTCAE) version 5, Proportion of patients with: - New malignancies. - Incidence/exacerbation of pre-existing neurologic disorder. - New incidence or exacerbation of a prior rheumatologic or other ATMP-CLINICAL TRIAL PROTOCOL OC-01-23002 EU CT Number: 2024-516617-20-00 Page 6 de 39 Protocol Version 1, 4 november 2024 autoimmune disorder. - New incidence of a hematologic disorder. - New incidence of infection (potentially product-related)- - New incidence of skin disorder
Endpoint(s): Overall survival following OC-1 cell therapy infusion, Progression-free survival, Progression-free survival in patients who did not received HSCT after OC-1 infusion, Proportion of patients who received an HSCT post OC-1 infusion, Persistence of OC-1, as determined by flow cytometry and quantitative analysis by qPCR. Genomic copy number integrations of the CAR in peripheral blood (PB) T cells and percentage of CD1a CAR-expressing T cells.

Source: https://euclinicaltrials.eu/ctis-public/view/2024-516617-20-00